EU clinical trial 2024-518563-35-00: A Phase 2a, Multi-Center, Randomized, Parallel Group, Double Blind and Placebo-controlled Clinical Trial to Assess Safety and Tolerability as well as Explorative Efficacy of the Orthosteric Selective Muscarinic M1 Agonist NSC001 in Mild to Moderate Alzheimer’s Disease
Protocol code: NSC24001
Sponsor: Nsc Therapeutics GmbH (Pharmaceutical company). Phase: Therapeutic exploratory (Phase II). Countries: Austria (ongoing, recruiting), Germany (ongoing, recruiting), Italy (ongoing, recruiting), Czechia (ongoing, recruiting).
Therapeutic area(s): Diseases [C] - Nervous System Diseases [C10]
Gender: Female, Male. Age: 18-64 years, 65+ years. Enrolment: 150.
Status: Ongoing, recruiting. Start date (EU): 2025-08-25. Decision date: 2025-04-06. Results received: No. Last updated: 2026-07-22.
Decision dates by country: AT: 2025-04-06, DE: 2025-04-22, CZ: 2026-05-04, IT: 2026-05-08

Condition(s): Alzheimer's Disease
Product: Trospium Aristo 20 mg Filmtabletten, Identical with the IMP NSC001 but without the active substance

Primary endpoint: Frequency and severity of AEs and SAEs, Changes in clinical/neurological findings, Changes in vital signs and ECG, Changes in laboratory assessments, Changes in suicidal ideation and suicidal behavior as assessed by C-SSRS
Endpoint(s): NSC001 (parent) PK parameters as applicable for the regimen including, but not limited to AUC(0 last), AUCinf, Cmax, tmax, CL/F (only parent), Vd/F (only parent), t½, % extrapolated AUCinf, Parent exposure ratios for Cmax and AUC(0-last)

Source: https://euclinicaltrials.eu/ctis-public/view/2024-518563-35-00